EU clinical trial 2024-517480-23-00: Induction treatment of patients with head and neck squamous cell carcinoma using simultaneous chemotherapy and low-dose radiotherapy (iCHRTL)
Protocol code: iCHRTL/2021
Sponsor: Narodowy Instytut Onkologii Im. Marii Sklodowskiej-Curie Panstwowy Instytut Badawczy (Hospital/Clinic/Other health care facility). Phase: Therapeutic exploratory (Phase II). Countries: Poland (ongoing, recruitment ended).
Therapeutic area(s): Diseases [C] - Neoplasms [C04]
Gender: Female, Male. Age: 18-64 years, 65+ years. Enrolment: 40.
Status: Ongoing, recruitment ended. Start date (EU): 2022-02-17. Decision date: 2024-12-09. Results received: No. Last updated: 2026-03-27.

Condition(s): Head and neck squamous cell carcinoma
Product: Carboplatin Pfizer, 10 mg/ml, roztwór do wstrzykiwań, Paclitaxel Kabi, 6 mg/ml, koncentrat do sporządzania roztworu do infuzji

Primary endpoint: Objective response rate after induction assessment (ORR), Local and nodal healing rate assessement (LRC), Assessment of the frequency of individual adverse events, Progression-free survival assessment (PFS), Overall survival assessment (OS)
Endpoint(s): Distant metastases rate assessment, Evaluation of the molecular and biochemical (immunological) effect of low doses of ionizing radiation, Relapse free survival (RFS) assessment

Source: https://euclinicaltrials.eu/ctis-public/view/2024-517480-23-00